EU clinical trial 2025-520737-23-00: Bioequivalence of Etonogestrel 68 mg Implant in Healthy Pre-Menopausal, Non-Pregnant Female Participants.
Protocol code: BLCL-ETN-ANV-02
Sponsor: Laboratorios Leon Farma S.A. (Pharmaceutical company). Phase: Human Pharmacology (Phase I)- Bioequivalence Study. Countries: Portugal (ended).
Therapeutic area(s): Not possible to specify
Gender: Female. Age: 18-64 years. Enrolment: 80.
Status: Ended. Start date (EU): 2025-07-07. End date (EU): 2026-03-31. Decision date: 2025-04-11. Results received: No. Last updated: 2026-01-21.

Condition(s): No medical condition.

Source: https://euclinicaltrials.eu/ctis-public/view/2025-520737-23-00